EU clinical trial 2023-505084-37-00: A Phase 1/2 Study of ASP1570 as Monotherapy and in Combination with Pembrolizumab and/or Standard Therapies Including Chemotherapy and/or Immunotherapy in Participants with Locally Advanced or Metastatic Solid Tumors
Protocol code: 1570-CL-0101
Sponsor: Astellas Pharma Global Development Inc. (Pharmaceutical company). Phase: Phase I and Phase II (Integrated)- First administration to humans. Countries: Spain (ended), France (ended).
Therapeutic area(s): Diseases [C] - Neoplasms [C04]
Gender: Female, Male. Age: 18-64 years, 65+ years. Enrolment: 98.
Status: Ended. Start date (EU): 2025-03-17. End date (EU): 2026-03-17. End date: 2026-03-18. Decision date: 2024-06-17. Results received: No. Last updated: 2026-03-17.
Decision dates by country: ES: 2024-06-17, FR: 2024-06-24

Condition(s): Advanced Solid Tumors
Product: ASP1570, ASP1570, KEYTRUDA 25 mg/mL concentrate for solution for infusion

Primary endpoint: Safety variables (e.g., incidence of DLTs and AEs; change from baseline in laboratory tests, vital signs and ECG)
Endpoint(s): ORR, DOR, and DCR of ASP1570 as monotherapy and in combination with pembrolizumab or standard therapies per iRECIST and RECIST 1.1, Selected pharmacokinetic parameters of ASP1570 as monotherapy and in combination with pembrolizumab or standard therapies in plasma: Cmax, tmax, AUCtau and Ctrough, Changes in tumor infiltration with CD4/CD8 cells and level of their proliferation (CD4/CD8, Ki67+)

Source: https://euclinicaltrials.eu/ctis-public/view/2023-505084-37-00